EU clinical trial 2023-505204-34-00: Phase 1, open-label, multicenter, dose escalation study of SRG-1505 as monotherapy in subjects with mature b-cell malignancies
Protocol code: SRG-1505-101
Sponsor: Schrodinger Inc. (Pharmaceutical company). Phase: Human Pharmacology (Phase I)- First administration to humans. Countries: France (ongoing, recruiting), Poland (ongoing, recruiting), Romania (ongoing, recruiting), Italy (ongoing, recruiting), Spain (ongoing, recruiting).
Therapeutic area(s): Diseases [C] - Neoplasms [C04]
Gender: Female, Male. Age: 18-64 years, 65+ years. Enrolment: 34.
Status: Ongoing, recruiting. Start date (EU): 2024-12-30. Decision date: 2023-09-27. Results received: No. Last updated: 2026-05-15.
Decision dates by country: IT: 2023-09-27, FR: 2024-01-08, RO: 2023-10-02, PL: 2023-10-02, ES: 2023-09-28

Condition(s): Mature B-Cell Neoplasm, Non-Hodgkin Lymphoma, Diffuse large B-cell lymphoma (DLBCL), Waldenstrom Macroglobulinemia, MALT Lymphoma, Follicular Lymphoma, Pediatric-Type Follicular Lymphoma, Large B-cell lymphoma with IRF4 rearrangement, Epstein-Barr virus (EBCV)–positive diffuse large B-cell lymphoma (DLBCL), Nos, Burkitt's Lymphoma, Plasmablastic Lymphoma, High-grade B-cell Lymphoma, Primary Cutaneous Follicle Center Lymphoma, Primary Effusion Lymphoma, Mantle Cell Lymphoma, Diffuse large B-cell lymphoma (DLBCL) Germinal Center B-Cell Type, Primary Mediastinal Large B Cell Lymphoma, T-Cell/Histiocyte-Rich Lymphoma, ALK-Positive Large B-Cell Lymphoma, Primary Cutaneous Diffuse Large B-Cell Lymphoma (DLBCL), Splenic Marginal Zone Lymphoma, Chronic Lymphocytic Leukemia, Nodal Marginal Zone Lymphoma, HHV8-Positive Diffuse large B-cell lymphoma (DLBCL), Nos Lymphoplasmacytic Lymphoma, Duodenal-Type Follicular Lymphoma

Source: https://euclinicaltrials.eu/ctis-public/view/2023-505204-34-00